EU clinical trial 2024-519163-18-00: COPD-2VAX: Enhancing Protection Against Respiratory Infections Through AS01-Mediated Innate Immune Activation in High-Risk Patients
Sponsor: Nordsjaellands Hospital (Hospital/Clinic/Other health care facility). Phase: Therapeutic use (Phase IV). Countries: Denmark (authorised, recruitment pending).
Therapeutic area(s): Diseases [C] - Virus Diseases [C02]
Gender: Female, Male. Age: 18-64 years, 65+ years. Enrolment: 60.
Status: Authorised, recruitment pending. Decision date: 2025-12-08. Results received: No. Last updated: 2025-12-08.

Condition(s): Chronic Obstructive Pulmonary Disease (COPD)
Product: Prevenar 20 suspension for injection in pre-filled syringe Pneumococcal polysaccharide conjugate vaccine (20-valent, adsorbed), Arexvy powder and suspension for suspension for injection Respiratory Syncytial Virus (RSV) vaccine (recombinant, adjuvanted), SALINE

Primary endpoint: Interferon-gamma (IFN-γ) Response. Measured as the increase in systemic IFN-γ levels at 24 hours post-vaccination compared to baseline.
Endpoint(s): NK Cell Activation. Change in Natural Killer (NK) cell activation markers (e.g., CD69 expression) 24 hours post-vaccination compared to baseline., Gene Signature of Innate Activation. The expression levels of a predefined set of genes associated with the interferon response (e.g., IRF7, IFIT1) measured via transcriptomic analysis of peripheral blood mononuclear cells (PBMCs) pre- and post-vaccination., Pneumococcal-Specific IgG Antibody Titers and Functional activity a. Increase in IgG GMCs for 12 pneumococcal serotypes included in PCV20, measured 30 days and 180 days post-vaccination. b. Assessment of functional pneumococcal antibodies through OPA for key serotypes, including serotype 3, at 30- and 180-day post-vaccination. c. Antibody glycosylation analysis (sialylation/desialylation), at 30- and 180-day post-vaccination, CD4+ T-cell Responses. Quantification of polyfunctional CD4+ T-cell responses (Th1-biased), as assessed by cytokine production (IFN-γ, TNF-α, IL-2) following ex vivo stimulation with RSV and pneumococcal antigens., RSV antibody titers. RSV pre-F-binding antibody titers will be quantified on samples obtained on days 0, 30, and 180, CD4 Responses. Directed against RSV and the conjugate protein of the pneumococcal vaccine.

Source: https://euclinicaltrials.eu/ctis-public/view/2024-519163-18-00